EU clinical trial 2025-520841-60-00: A multi-centre, single-arm study to demonstrate the efficacy of bone marrow allogeneic mesenchymal cells combined with biomaterial (combined ATMP) for bone healing in delayed union and non-union after long bone fractures (OrthoAlloUnion).
Protocol code: Ortho-Allo-Union
Sponsor: Fundacion Para La Investigacion Biomedica Del Hospital Universitario Puerta De Hierro Majadahonda (Patient organisation/association). Phase: Therapeutic confirmatory (Phase III). Countries: Spain (authorised, recruiting), Italy (authorised, recruitment pending), France (authorised, recruitment pending), Germany (not authorised).
Therapeutic area(s): Diseases [C] - Musculoskeletal Diseases [C05]
Gender: Female, Male. Age: 18-64 years, 65+ years. Enrolment: 80.
Start date (EU): 2026-04-24. Decision date: 2025-09-26. Results received: No. Last updated: 2026-08-08.
Decision dates by country: DE: 2025-09-29, ES: 2025-09-26, FR: 2025-09-26, IT: 2026-08-08

Condition(s): Delayed consolidation or non-union long bone fracture
Product: ORTHOALLO-BM-MSC

Primary endpoint: Percentage of patients with radiological consolidation (Yes/No) at 12 months after the intervention.
Endpoint(s): Percentage of patients with radiological bone consolidation (Yes/No) at 6 months after the intervention., Value of Reborne scale at 6 and 12 months, Pain score at preoperative, 6 and 12 months after surgery, using Numeric Rating Score (NRS) (from 0 to 10) with and without weight bearing., Percentage of patients with reoperation at the callus site (Yes/No) at 6 and 12 months after surgical intervention. Estimated as the number of reoperations in the callus site, over the total number of treated patients., Percentage of patients with bone consolidation (Yes/No) at 6 and 12 months after the intervention. Estimated as the number of bone consolidations, over the total number of treated patients., Volumetric assessment of the regenerated bone, as a percentage of 10cm3 of the affected long bone, applying the Region of Interest methodology using Osirix® software in full CT images, at preoperative, 6 and 12 months after surgery, Safety endpoints include: - Early complication rate: percentage of patients with complications within the first 3 months after surgery. - Overall complication rate as percentage of patients with local or general complications regarding potential effects of the treatment at any time after surgery.

Source: https://euclinicaltrials.eu/ctis-public/view/2025-520841-60-00